EU clinical trial 2023-504867-18-00: A Long-term Extension (LTE) Study to Characterize the Safety and Efficacy of Danicopan as an Add-on Therapy to a Complement Component 5 Inhibitor (C5i) in Patients with Paroxysmal Nocturnal Hemoglobinuria (PNH) Previously Treated with Danicopan in an Alexion-sponsored Clinical Study.
Protocol code: ALXN2040-PNH-303
Sponsor: Alexion Pharmaceuticals Inc. (Pharmaceutical company). Phase: Therapeutic confirmatory (Phase III). Countries: France (ended), Czechia (ended), Greece (ended), Italy (ended), Spain (ended), Poland (ended).
Therapeutic area(s): Diseases [C] - Immune System Diseases [C20]
Gender: Female, Male. Age: 18-64 years, 65+ years. Enrolment: 25.
Status: Ended. Start date (EU): 2022-12-05. End date (EU): 2026-06-11. Decision date: 2024-07-04. Results received: No. Last updated: 2026-05-22.
Decision dates by country: FR: 2024-07-04, ES: 2024-07-04, GR: 2024-07-22, PL: 2024-07-10, CZ: 2024-07-08, IT: 2024-07-08

Condition(s): Patients with Paroxysmal Nocturnal Hemoglobinuria
Product: Ultomiris 300 mg/30 mL concentrate for solution for infusion, Soliris 300 mg concentrate for solution for infusion, ALXN 2040

Primary endpoint: Incidence of treatment-emergent adverse events (TEAEs) and serious TEAEs
Endpoint(s): Change in hemoglobin (Hgb) values over time, Proportion of patients with Hgb increase of ≥ 2g/dL in the absence of transfusion over time, Change in absolute reticulocyte count over time, Change in lactate dehydrogenase (LDH) over time, Proportion of patients with LDH ≤ 1.5 × upper limit of normal (ULN) over time, Proportion of patients with transfusion avoidance (TA), defined as patients who remain transfusion free and do not require transfusion as per protocol specified guidelines, Change in FACIT Fatigue scores over time, Change in EORTC-QLQ-C30 scores over time, Change in safety laboratory parameters over time, TEAEs leading to discontinuation

Source: https://euclinicaltrials.eu/ctis-public/view/2023-504867-18-00